EU clinical trial 2025-523411-11-00: An open label, balanced, randomized, three treatment, three period, three sequence, single dose, crossover study to assess the effect of food and effect of apple sauce on bioavailability of the Test product (Bupropion Hydrochloride Extended Release Capsules 150 mg, manufactured by Sun Pharmaceutical Industries Limited, India) in healthy, adult, human subjects.
Protocol code: BUPRO-06-25
Sponsor: Sun Pharmaceutical Industries Limited (Pharmaceutical company). Phase: Human Pharmacology (Phase I)- Other. Countries: Romania (authorised, recruitment pending).
Therapeutic area(s): Psychiatry and Psychology [F] - Mental Disorders [F03]
Gender: Female, Male. Age: 18-64 years. Enrolment: 72.
Status: Authorised, recruitment pending. Decision date: 2026-05-05. Results received: No. Last updated: 2026-05-05.

Condition(s): Seasonal affective disorder, Major depressive disorder

Source: https://euclinicaltrials.eu/ctis-public/view/2025-523411-11-00